EU clinical trial 2022-502001-15-00: BRIGHT - A Phase II, Double-Blind, Randomized, Placebo-Controlled Study to Evaluate the Safety and Efficacy of Multiple Doses of LT3001 Drug Product in Subjects with Acute Ischemic Stroke (AIS)
Protocol code: LT3001-205
Sponsor: Lumosa Therapeutics Co. Ltd. (Pharmaceutical company). Phase: Therapeutic exploratory (Phase II). Countries: Spain (ended), Czechia (ended), Germany (ended), Italy (ended), Greece (ended), Portugal (ended).
Therapeutic area(s): Diseases [C] - Nervous System Diseases [C10]
Gender: Female, Male. Age: 18-64 years, 65+ years. Enrolment: 96.
Status: Ended. Start date (EU): 2023-12-05. End date (EU): 2025-05-23. End date: 2025-05-24. Decision date: 2023-09-04. Results received: Yes. Last updated: 2025-05-23.
Decision dates by country: PT: 2023-09-05, IT: 2023-09-06, ES: 2023-09-04, DE: 2023-09-06, CZ: 2023-09-05, GR: 2023-09-04

Condition(s): Acute Ischemic Stroke (AIS)
Product: Placebo, LT3001 Drug Product

Primary endpoint: The proportion of subjects with Adverse Events (AEs), judged to be probably or definitely related to the investigational product (IP) within 90 days after the 1st IP administration.

Source: https://euclinicaltrials.eu/ctis-public/view/2022-502001-15-00